EU clinical trial 2023-507516-12-00: A Phase 2 Study of Futibatinib in Combination with PD-1 Antibody-based Standard of Care Therapy in Patients with Solid Tumors
Protocol code: TAS-120-206
Sponsor: Taiho Oncology Inc. (Pharmaceutical company). Phase: Therapeutic exploratory (Phase II). Countries: Spain (ongoing, recruitment ended), France (ended), Germany (ended).
Therapeutic area(s): Diseases [C] - Neoplasms [C04]
Gender: Female, Male. Age: 18-64 years, 65+ years. Enrolment: 15.
Start date (EU): 2024-05-08. Decision date: 2024-03-04. Results received: No. Last updated: 2026-03-10.
Decision dates by country: ES: 2024-03-07, FR: 2024-03-06, DE: 2024-03-04

Condition(s): Solid Tumors
Product: CAMPTO 20 mg/mL concentrate for solution for infusion, Futibatinib, Leucovorin-Teva 10 mg/ml Concentrate for Solution for Infusion, FLUOROURACIL, CISPLATIN, OXALIPLATIN, KEYTRUDA 25 mg/mL concentrate for solution for infusion

Primary endpoint: Objective response rate (ORR) by Response Evaluation Criteria in Solid Tumors (RECIST) 1.1 by investigator assessment
Endpoint(s): Safety based on AEs, SAEs, dose modifications, clinical laboratory parameters, vital signs, electrocardiograms (ECGs), and ophthalmological exams, Duration of response (DoR) by investigator assessment, Disease control rate (DCR) by investigator assessment, Progression-free survival (PFS) by investigator assessment, 6-month PFS rate by investigator assessment

Source: https://euclinicaltrials.eu/ctis-public/view/2023-507516-12-00